EU clinical trial 2024-513569-38-00: C5041006 (APD334 202 or APD334-202EU): A Multicenter, Randomized, Double Blind, Parallel Group Study to Assess the Efficacy and Safety of Oral Etrasimod as Induction and Maintenance Therapy for Moderately to Severely Active Crohn’s Disease
Protocol code: C5041006
Sponsor: Arena Pharmaceuticals Inc. (Pharmaceutical company). Phase: Phase II and Phase III (Integrated). Countries: Austria (ended), Denmark (ended), Poland (ended), Netherlands (ended), France (ended), Bulgaria (ended), Spain (ended), Italy (ended), Czechia (ended), Germany (ended), Croatia (ended), Slovakia (ended), Belgium (ended), Hungary (ended), Greece (ended).
Therapeutic area(s): Diseases [C] - Digestive System Diseases [C06]
Gender: Female, Male. Age: 18-64 years, 65+ years. Enrolment: 367.
Status: Ended. Start date (EU): 2021-07-09. End date (EU): 2025-01-22. End date: 2025-06-09. Decision date: 2024-09-03. Results received: Yes. Last updated: 2025-05-07.
Decision dates by country: AT: 2024-09-08, BG: 2024-09-13, HR: 2024-09-03, DK: 2024-09-10, FR: 2024-09-10, DE: 2024-09-06, GR: 2024-11-20, HU: 2024-09-03, ES: 2024-09-09, NL: 2024-09-08, PL: 2024-09-10, SK: 2024-09-04, BE: 2024-09-06, CZ: 2024-09-05, IT: 2024-09-23

Condition(s): Crohn's Disease
Product: Etrasimod Arginine Blue Placebo, Etrasimod Arginine Blue, Etrasimod Arginine Blue

Primary endpoint: SSA-P2:Proportion of subjects with endoscopic response, SS1-P2b:Proportion of subjects with endoscopic response at Week 14, SS2-I: • Proportion of subjects with endoscopic response at Week 14. • Proportion of subjects with clinical remission CDAI at Week 14, SS3-M: • Proportion of subjects with clinical remission CDAI at Week 52 • Proportion of subjects with endoscopic response at Week 52
Endpoint(s): SSA-P2:• Proportion of subjects with clinical remission CDAI • Change from baseline in SES-CD score • Change from baseline in CDAI score. •Etrasimod plasma concentrations at 4 hours postdose and at steady-state trough concentrations at selected timepoints.• Change and percentage change from baseline in ALC., SS1-P2b:• Proportion of subjects with clinical remission CDAI at Week 14 • Proportion of subjects with clinical remission by PRO2 at Week 14, SS2-I:• Proportion of subjects with clinical remission PRO2 at Week 14 • Proportion of subjects with clinical response CDAI at Week 14 • Proportion of subjects with endoscopic response and clinical remission CDAI at Week 14 • Proportion of subjects with endoscopic remission at Week 14 •, SS3-M: • Proportion of subjects with clinical remission CDAI at Week 52 among subjects in clinical remission CDAI at SS3-M baseline • Proportion of subjects with endoscopic response at Week 52 among subjects in endoscopic response at SS3-M baseline, SS4-E:• Proportion of subjects with clinical remission CDAI by visit up to the end of treatment • Proportion of subjects with clinical remission PRO2 by visit up to the end of treatment

Source: https://euclinicaltrials.eu/ctis-public/view/2024-513569-38-00